EU clinical trial 2024-511001-28-00: A PROSPECTIVE RANDOMIZED PHASE II STUDY TO ASSESS THE SCHEMAS OF RETREATMENT WITH LUTATHERA® ([177LU]LU-DOTA-TATE) IN PATIENTS WITH NEW PROGRESSION OF INTESTINAL WELL-DIFFERENTIATED NEUROENDOCRINE TUMOR
Protocol code: PROICM 2021-04 REL
Sponsor: Institut Regional Du Cancer De Montpellier (Hospital/Clinic/Other health care facility). Phase: Therapeutic exploratory (Phase II). Countries: France (ongoing, recruiting).
Therapeutic area(s): Diseases [C] - Neoplasms [C04]
Gender: Female, Male. Age: 18-64 years, 65+ years. Enrolment: 209.
Status: Ongoing, recruiting. Start date (EU): 2021-12-13. Decision date: 2024-04-05. Results received: No. Last updated: 2026-05-04.
Decision dates by country: FR: 2024-05-16

Condition(s): Neuroendocrine tumor
Product: Lutathera 370 MBq/mL solution for infusion, LysaKare 25 g/25 g solution for infusion

Primary endpoint: Disease Control Rate (DCR) at 6 months from randomization (defined as Complete Response, Partial Response and Stable Disease from RECIST v1.1 with an evaluation every 2 months.
Endpoint(s): The Safety according to NCI-CTCAE v5.0, rPFS defined as the time from randomization until documented disease progression on radiological tumor assessment (as evaluated by an independent central review by radiologists blindly of the treatment assignments according to RECIST v1.1) or death from any cause, whichever occurs first., PFS defined as the time from randomization until documented disease progression on radiological tumor assessment (as evaluated by an independent central review by radiologists blindly of the treatment assignments according to RECIST v1.1) or clinical progression or death from any cause, whichever occurs first, OS defined as the time from randomization until death from any cause., QoL assessed by EORTC QLQ-C30 and EORTC GI.NET21 questionnaires

Source: https://euclinicaltrials.eu/ctis-public/view/2024-511001-28-00